EU clinical trial 2024-512872-36-00: TOCOPROM - Tocolysis in the management of preterm premature rupture of membranes before 34 weeks of gestation: a double-blinded randomized controlled trial
Protocol code: P160917
Sponsor: Assistance Publique Hopitaux De Paris (Hospital/Clinic/Other health care facility). Phase: Therapeutic confirmatory (Phase III). Countries: France (ongoing, recruiting).
Therapeutic area(s): Diseases [C] - Female Urogenital Diseases and Pregnancy Complications [C13]
Gender: Female. Age: 18-64 years. Enrolment: 850.
Status: Ongoing, recruiting. Start date (EU): 2024-07-25. Decision date: 2024-07-25. Results received: No. Last updated: 2026-03-13.

Condition(s): obstetric_pathological delivery
Product: NIFEDIPINE, Placebo of Nifedipine

Primary endpoint: The primary endpoint is a composite outcome including fetal death, neonatal death up to discharge from hospital and/or neonatal severe morbidity.
Endpoint(s): Prolongation of gestation - Maternal morbidity - Neonatal minor morbidity - Outcomes at 2 years of corrected age

Source: https://euclinicaltrials.eu/ctis-public/view/2024-512872-36-00